EU clinical trial 2024-516032-10-00: A study to investigate the mechanistic effects of dapagliflozin alone or in combination with balcinrenone, compared to balcinrenone and placebo on body fluid and electrolyte handling and energy metabolism in participants over 50 years of age with chronic kidney disease (DapaBalci-Leap)
Protocol code: CT114-2022-01
Sponsor: Winicker-Norimed Medizinische Forschung GmbH, Klinikum Nuernberg (Pharmaceutical company, Hospital/Clinic/Other health care facility). Phase: Therapeutic exploratory (Phase II). Countries: Germany (ended), France (ended).
Therapeutic area(s): Diseases [C] - Male Urogenital Diseases [C12]
Gender: Female, Male. Age: 18-64 years, 65+ years. Enrolment: 150.
Status: Ended. Start date (EU): 2023-07-13. End date (EU): 2026-01-28. Decision date: 2024-08-13. Results received: No. Last updated: 2025-12-01.
Decision dates by country: FR: 2024-08-13, DE: 2024-08-13

Condition(s): Stage 3 chronic kidney disease
Product: DAPAGLIFLOZIN, Placebo for Dapagliflozin, balcinrenone, balcinrenone, Placebo for Balcinrenone

Primary endpoint: Change from baseline in 24h urine glucose excretion at day 3 and day 28
Endpoint(s): Change from baseline in urine osmolality at day 3 and day 28, Change from baseline in urine glucose fraction at day 3 and day 28, Change from baseline in urine sodium fraction at day 3 and day 28; Change from baseline in urine urea fraction at day 3 and day 28, Change from baseline in urine potassium fraction after 48h and after 4 weeks, Change from baseline in muscle water content as measured at 7T MRI at day 28, Change from baseline in copeptin levels at day 3 and day 28, Change from baseline in plasma insulin/glucagon ratio at day 3 and day 28, Change from baseline in tissue Na+ content at day 28, Change from baseline in urine lithium/sodium excretion ratio at day 3 and day 28, Change from baseline in 24h urine indoxyl sulfate and indole 3 acetic acid excretion at day 28, Change from baseline in pH levels and phosphate metabolites levels at day 28 as quantified with 31P spectroscopy at 3T MRI, Change from baseline in 24h urine aldosterone levels at day 3 and day 28, Change from baseline in glucose-6-P Dehydrogenase activity at day 28, Change from baseline in GSH/GSSG ratio in the erythrocytes at day 28, Change from baseline in γ-glutamyl cysteine and glutathione synthase activity in the erythrocytes at day 28, Change from baseline in the cataplerotic component of the pentose phosphate pathway in erythrocytes at day 28, Change from baseline in the anaplerotic component of the pentose phosphate pathway in erythrocytes at day 28, Change from baseline in glutathione reductase, band 4.1a/4.1b protein, and creatine levels at day 28, Incidence and severity of treatment-emergent AEs, Changes in safety laboratory values from baseline to day 28, Changes in vital signs from baseline to day 28

Source: https://euclinicaltrials.eu/ctis-public/view/2024-516032-10-00